EU clinical trial 2025-522217-27-00: The effect of SYX-5219 on an immune response in the skin.
Protocol code: SYX-5219-102
Sponsor: Sitryx Therapeutics Limited (Pharmaceutical company). Phase: Human Pharmacology (Phase I)- Other. Countries: Netherlands (ended).
Therapeutic area(s): Diseases [C] - Skin and Connective Tissue Diseases [C17]
Gender: Female, Male. Age: 18-64 years. Enrolment: 20.
Status: Ended. Start date (EU): 2025-11-19. End date (EU): 2026-03-20. Decision date: 2025-11-14. Results received: No. Last updated: 2025-11-14.

Condition(s): Atopic dermatitis (AD)

Source: https://euclinicaltrials.eu/ctis-public/view/2025-522217-27-00